EU clinical trial 2024-512175-12-00: A PHASE I STUDY OF XXX AS SINGLE AGENT OR IN COMBINATION WITH ANTI-PD-1 ANTIBODY IN SOLID CANCERS AND A RANDOMIZED COHORT EXPLORING THE COMBINATION OF XXX WITH XXX VS STANDARD OF CARE IN CANCER PATIENTS
Protocol code: LCB-2401-001
Sponsor: NovImmune SA (Pharmaceutical company). Phase: Human Pharmacology (Phase I)- First administration to humans. Countries: Spain (ongoing, recruiting).
Therapeutic area(s): Diseases [C] - Neoplasms [C04]
Gender: Female, Male. Age: 18-64 years, 65+ years. Enrolment: 50.
Status: Ongoing, recruiting. Start date (EU): 2024-07-29. Decision date: 2024-06-11. Results received: No. Last updated: 2026-07-27.

Condition(s): Low and medium tumour volume (LTV/MTV) advanced, metastatic, or recurrent solid malignancies expressing carcinoembryonic antigen-related cell adhesion molecule 5 (CEACAM5, also known as CEA).

Source: https://euclinicaltrials.eu/ctis-public/view/2024-512175-12-00